EU clinical trial 2024-516673-68-00: PATHOS : A Phase III trial of risk-stratified, reduced intensity adjuvant treatment in patients undergoing transoral surgery for Human papillomavirus (HPV)-positive oropharyngeal cancer
Protocol code: SPON1610-17
Sponsor: Cardiff University (Educational Institution). Phase: Therapeutic confirmatory (Phase III). Countries: France (ongoing, recruitment ended), Germany (ongoing, recruitment ended).
Therapeutic area(s): Diseases [C] - Neoplasms [C04]
Gender: Female, Male. Age: 18-64 years, 65+ years. Enrolment: 240.
Status: Ongoing, recruitment ended. Start date (EU): 2020-10-27. Decision date: 2025-01-16. Results received: No. Last updated: 2025-01-17.
Decision dates by country: FR: 2025-01-16, DE: 2025-01-17

Condition(s): Human papillomavirus (HPV)-positive oropharyngeal cancer
Product: CISPLATIN, CARBOPLATIN

Primary endpoint: Overall survival and swallowing function as measured by the MD Anderson Dysphagia Inventory (MDADI) score.
Endpoint(s): Swallowing panel measurements including qualitative and quantitative swallowing assessments as described previously., QOL (using EORTC QLQ C30 and HN35 questionnaires)., Acute and late toxicity, assessed using NCI CTCAE criteria version 4.03, Overall survival, disease free survival, locoregional control, distant metastases.

Source: https://euclinicaltrials.eu/ctis-public/view/2024-516673-68-00